EU clinical trial 2024-515619-23-00: Ruxolitinib versus Best Available Therapy in patients with high-risk polycythemia vera or high-risk essential thrombocythemia – The Ruxo-BEAT Trial
Protocol code: 12-181
Sponsor: Universitaetsklinikum Aachen AöR (Hospital/Clinic/Other health care facility). Phase: Therapeutic exploratory (Phase II). Countries: Germany (ongoing, recruitment ended).
Therapeutic area(s): Diseases [C] - Hemic and Lymphatic Diseases [C15]
Gender: Female, Male. Age: 18-64 years, 65+ years. Enrolment: 223.
Status: Ongoing, recruitment ended. Start date (EU): 2015-06-29. Decision date: 2024-08-09. Results received: No. Last updated: 2026-06-09.

Condition(s): polycythemia vera, essential thrombocythemia
Product: Jakavi 20 mg tablets, Jakavi 5 mg tablets

Primary endpoint: The rate of complete clinicohematologic responses (CHR) at month 6, compared to baseline, as defined by (Barosi, et al., 2009).
Endpoint(s): Safety of both regimens., The rate of complete clinicohematologic responses (CHR) at month 12 and month 24 as defined by Barosi et al. Blood 2009 (with the clinical modification that splenomegaly assessment may be done by ultrasound or palpation)., To determine the complete response (CR) rate at month 6 as defined by Barosi et al. Blood 2013 (revised ELN response criteria, see section 15.6) (Barosi, et al., 2013)., The efficacy as assessed by both the absence of phlebotomy (Hct <45%) and reduction in spleen size (palpable spleen that is reduced by > 50% from baseline measured by palpation or ultrasound) OR platelet count < 600 x 10^9/l (ET) at month 6 and month 24, The proportion of subjects achieving both durable absence of phlebotomy eligibility and durable spleen size reduction measured by palpation (PV) OR durable platelet count < 600 x 10^9/l (ET) (durable defined as > 3 months) (Barosi et al. 2009/2013) at month 6, month 12 and month 24., The rate of overall clinicohematologic responses (CR + PR) according to both guidelines (Barosi et al. 2009 and 2013) at month 6 and month 24.

Source: https://euclinicaltrials.eu/ctis-public/view/2024-515619-23-00